EU clinical trial 2023-504616-15-02: Rectally administered micronized progesterone for luteal phase support in hormone replacement therapy frozen embryo transfer (HRT-FET) cycle – non-inferiority randomized controlled trial
Sponsor: Region Midtjylland (Hospital/Clinic/Other health care facility). Phase: Therapeutic confirmatory (Phase III). Countries: Denmark (ongoing, recruiting).
Therapeutic area(s): Diseases [C] - Female Urogenital Diseases and Pregnancy Complications [C13]
Gender: Female. Age: 18-64 years. Enrolment: 618.
Status: Ongoing, recruiting. Start date (EU): 2024-05-14. Decision date: 2023-11-22. Results received: No. Last updated: 2024-04-08.

Condition(s): Infertility
Product: Estrofem 2 mg Filmtabletten, Cyclogest 400mg

Primary endpoint: Ongoing pregnancy rate week 12 after HRT-FET with rectally administered progesterone, only.
Endpoint(s): Positive hCG rate,, Clinical pregnancy,, Pregnancy loss,, LBR,, Mean P4 levels in Group B (study group) and the relation to OPR., Urine progesterone levels in the two groups and the relation to OPR., Side effects and patient convenience regarding rectally administration of Cyclogest., Complications during the pregnancy e.g. hypertension and preeclampsia.

Source: https://euclinicaltrials.eu/ctis-public/view/2023-504616-15-02